EU clinical trial 2023-503570-20-00: C4671052- A Phase 1, Randomized, Fixed Sequence, Multiple-Dose, Open-Label Study to Estimate the Effect of Nirmatrelvir (PF-07321332)/Ritonavir on Rosuvastatin Pharmacokinetics in Healthy Adult Participants
Protocol code: C4671052
Sponsor: Pfizer Inc. (Pharmaceutical company). Phase: Human Pharmacology (Phase I)- Other. Countries: Belgium (ended).
Therapeutic area(s): Diseases [C] - Virus Diseases [C02]; Diseases [C] - Respiratory Tract Diseases [C08]
Gender: Female, Male. Age: 18-64 years, 65+ years. Enrolment: 12.
Status: Ended. Start date (EU): 2023-06-02. End date (EU): 2023-08-10. End date: 2023-08-11. Decision date: 2023-05-24. Results received: Yes. Last updated: 2023-07-13.

Condition(s): coronavirus disease 2019 (COVID-19)
Product: NIRMATRELVIR, Crestor 10 mg, comprimés pelliculés., Norvir 100 mg film-coated tablets

Primary endpoint: AUCinf and Cmax of rosuvastatin
Endpoint(s): AUClast, Tmax, t½, CL/F, and Vz/F of rosuvastatin, Vital signs, laboratory tests and adverse events

Source: https://euclinicaltrials.eu/ctis-public/view/2023-503570-20-00